EU clinical trial 2024-517304-12-00: A Randomized Double-Blind Placebo-Controlled Cross-Over Trial of the Safety, Tolerability, and Efficacy of PN6047 HCl in Peripheral Neuropathic Pain Characterized by Mechanical Allodynia
Sponsor: Pharmnovo AB (Pharmaceutical company). Phase: Therapeutic exploratory (Phase II). Countries: Spain (authorised, recruitment pending).
Therapeutic area(s): Diseases [C] - Nervous System Diseases [C10]
Gender: Female, Male. Age: 18-64 years, 65+ years. Enrolment: 25.
Status: Authorised, recruitment pending. Decision date: 2025-09-30. Results received: No. Last updated: 2026-05-25.

Condition(s): Mechanical allodynia
Product: Matched Placebo

Primary endpoint: • Safety parameters to be recorded throughout the trial: o Laboratory values, vital signs, physical examination including neurological examination, and electrocardiogram (ECG), evaluated with regard to change from Baseline where appropriate and with regard to abnormalities found and clinical significance, • Safety parameters to be recorded throughout the trial: Adverse events (AEs), assessed with regard to intensity, seriousness, and causality
Endpoint(s): • Pain assessments: Change of “Average Pain” Intensity (last 12 hours) rated on Numerical Rating Scale (NRS; 0-10, twice daily) from 5-days Baseline to the last 5 days of each treatment period, • Pain assessments: Change of Touch-Evoked Pain Intensity (“Pain caused by touch/contact” with the painful skin area during the night/day) rated on NRS (0-10) from 5-days Baseline to the last 5 days of each treatment period, • Pain assessments: Change from Baseline in Pain Interference with sleep, daily activities, and mood, respectively, during the last 24 hours, rated on NRS (0-10), • Pain assessments: Change in Neuropathic Pain Symptom Inventory (NPSI) total score and its 5 subdimensions during each treatment period, • Pain assessments: Pain relief experienced during each treatment period, rated on a Pain Relief Scale (none, a little, some, a lot, complete), • Pain assessments: The change in consumption of rescue medication (paracetamol) from 5-days Baseline to the last 5 days of each treatment period, Change from Baseline to the last day of each treatment period of the intensity (NRS, 0-10) of dynamic mechanical allodynia, as evoked by standardised brush strokes in the skin area of maximal pain, Change from Baseline to the last day of each treatment period in the area of dynamic mechanical allodynia, using strokes with a standardised brush, Descriptive statistics of plasma concentrations of PN6047 HCl in participants receiving active treatment, at -15 min (±14 min, pre-dose), +30 min, +60 min, +90 min, and +4 h after dose on Days 7, 20, 35, and 48. On Day 29, only a pre-dose sample will be collected

Source: https://euclinicaltrials.eu/ctis-public/view/2024-517304-12-00